EU clinical trial 2026-526867-39-00: Nav 1.8 and 1.7 combo trial
Protocol code: NR-2501-2507-2603
Sponsor: Niroda Therapeutics Inc. (Pharmaceutical company). Phase: Human Pharmacology (Phase I)- Other. Countries: Netherlands (authorised, recruiting).
Therapeutic area(s): Diseases [C] - Nervous System Diseases [C10]
Gender: Female, Male. Age: 18-64 years. Enrolment: 96.
Status: Authorised, recruiting. Start date (EU): 2026-07-31. Decision date: 2026-07-30. Results received: No. Last updated: 2026-07-30.

Condition(s): Pain

Source: https://euclinicaltrials.eu/ctis-public/view/2026-526867-39-00